EU clinical trial 2025-525005-20-00: A Multicenter Randomized Controlled Trial Assessing the Efficacy and Safety of Recombinant Human Follicle Stimulating Hormone (r-hFSH-alfa originator) and Human Chorionic Gonadotropin (hCG) in Enhancing Sperm Concentration in Men with Oligozoospermia, Low Testosterone, and Normal FSH Serum Levels (APHRODITE Group 3): A Collaborative Research Initiative
Protocol code: MATES Study
Sponsor: Martin-Luther-Universitaet Halle-Wittenberg (Educational Institution). Phase: Therapeutic use (Phase IV). Countries: Italy (authorised, recruitment pending), Spain (authorised, recruitment pending), Germany (authorised, recruitment pending).
Therapeutic area(s): Phenomena and Processes [G] - Reproductive and Urinary Physiological Phenomena [G08]
Gender: Male. Age: 18-64 years. Enrolment: 138.
Status: Authorised, recruitment pending. Decision date: 2026-05-18. Results received: No. Last updated: 2026-05-25.
Decision dates by country: DE: 2026-05-19, IT: 2026-05-18, ES: 2026-05-25

Condition(s): Male Infertility
Product: GONASI HP 250 U.I. / 1 ml polvere e solvente per soluzione iniettabile, GONAL-f 900 IU/1.44 mL solution for injection in pre-filled pen

Primary endpoint: The primary endpoint of the study will be the evaluation of sperm concentration (Ml/ml) on the last day of treatment (week 16) compared to the untreated arm

Source: https://euclinicaltrials.eu/ctis-public/view/2025-525005-20-00